EU clinical trial 2024-517675-20-00: Oxytocin versus Prostaglandins for labor Induction of women with an unfavorable Cervix after 24 hours of cervical ripening: a multicenter non inferiority randomized trial (OPIC)
Protocol code: DR200090
Sponsor: Centre Hospitalier Regional Universitaire De Tours (Hospital/Clinic/Other health care facility). Phase: Phase III and phase IV (Integrated). Countries: France (ongoing, recruiting).
Therapeutic area(s): Phenomena and Processes [G] - Reproductive and Urinary Physiological Phenomena [G08]
Gender: Female. Age: 18-64 years. Enrolment: 1494.
Status: Ongoing, recruiting. Start date (EU): 2021-09-28. Decision date: 2024-12-10. Results received: No. Last updated: 2026-07-17.

Condition(s): Labor Induction of women with an unfavorable Cervix after 24 hours of cervical ripening
Product: PROPESS 10 mg, système de diffusion vaginal, ANGUSTA 25 microgrammes, comprime, OXYTOCINE PANPHARMA 5 UI/1 ml, solution injectable, PROSTINE E2 2 mg/3 g, gel vaginal

Primary endpoint: Rate of caesarean delivery, whatever the indication of the caesarean delivery
Endpoint(s): Time from intervention to delivery in hours, Delivery within 12 hours, Maternal satisfaction, Need for induction with oxytocin (for women in the control group), Indication of caesarean in case of caesarean delivery, Instrumental delivery, Indication for the use of instruments in case of instrumental delivery, Oxytocin augmentation, Uterine hyperstimulation, Suspicion of per-partum infection, Post-partum haemorrhage, Severe post-partum haemorrhage, Anal sphincter injury, Blood transfusion, Need for antibiotics, Length of hospital stay, Cardiorespiratory arrest, Damage to internal organs, Hysterectomy for any complications resulting from birth, Pulmonary embolus, Stroke, Admission to intensive care unit, Maternal death, Neonatal morbidity: birth trauma, Neonatal morbidity: hypoxic ischaemic encephalopathy, Neonatal morbidity: need for therapeutic hypothermia, Neonatal morbidity: meconium aspiration syndrome, Neonatal morbidity: need for respiratory support, Neonatal morbidity: neonatal seizures, Neonatal morbidity: neonatal acidosis, Neonatal morbidity: Early neonatal infection, Neonatal morbidity: Admission in an intensive care unit, Neonatal morbidity: death of the baby, Proportion of incremental cost-effect pairs that lies into the non-inferiority area, for various values of economic non–inferiority margin, and for a constant clinical non-inferiority margin (7%).

Source: https://euclinicaltrials.eu/ctis-public/view/2024-517675-20-00